EU clinical trial 2023-504605-36-00: FIRST-IN-HUMAN STUDY OF IPH5301 TREATMENT ALONE OR IN COMBINATION WITH CHEMOTHERAPY AND TRASTUZUMAB IN PATIENTS WITH ADVANCED SOLID TUMORS
Protocol code: CHANCES-IPC 2021-008
Sponsor: Institut Paoli-Calmettes (Hospital/Clinic/Other health care facility). Phase: Human Pharmacology (Phase I)- First administration to humans. Countries: France (ongoing, recruitment ended), Belgium (ongoing, recruitment ended).
Therapeutic area(s): Diseases [C] - Neoplasms [C04]
Gender: Female, Male. Age: 18-64 years, 65+ years. Enrolment: 25.
Status: Ongoing, recruitment ended. Start date (EU): 2022-01-21. Decision date: 2023-08-02. Results received: No. Last updated: 2025-06-05.
Decision dates by country: BE: 2023-11-23, FR: 2023-08-02

Condition(s): Dose escalation cohort: advanced and/or metastatic cancer car-cinoma of the breast, stomach, esophagus, pancreas, endometri-um, ovary or lung. Expansion cohort: HER2-expressing, i.e HER2-positive and HER2-low breast cancer

Source: https://euclinicaltrials.eu/ctis-public/view/2023-504605-36-00